EU clinical trial 2024-516672-16-00: A 96-Week, Prospective, Multicenter, Randomised, Double-Blind, Placebo-Controlled, Phase 3 Study to Compare Efficacy and Safety of Masitinib Dose Titration to 4.5 mg/kg/day versus Placebo in the Treatment of Patients with Primary Progressive or Secondary Progressive Multiple Sclerosis Without Relapse
Protocol code: AB20009
Sponsor: Ab Science (Pharmaceutical company). Phase: Therapeutic confirmatory (Phase III). Countries: Greece (ended), Spain (ended), Poland (ended), France (ended).
Therapeutic area(s): Diseases [C] - Nervous System Diseases [C10]
Gender: Female, Male. Age: 18-64 years, 65+ years. Enrolment: 145.
Status: Ended. Start date (EU): 2024-02-02. End date (EU): 2026-07-03. Decision date: 2025-01-30. Results received: No. Last updated: 2025-12-01.
Decision dates by country: FR: 2025-01-30, GR: 2025-01-31, ES: 2025-01-30, PL: 2025-01-30

Condition(s): Multiple Sclerosis
Product: masitinib, Placebo to 200mg masitinib, Placebo to 100mg masitinib, masitinib

Primary endpoint: The primary endpoint is to assess the efficacy of masitinib 3.0 mg/kg/day with a dose escalation to 4.5 mg/kg/day after four weeks on the time to confirmed (12-weeks CDP) EDSS progression. Progression is defined as 1-point worsening when EDSS score ≤5.5, or 0.5-point worsening if baseline score >5.5.
Endpoint(s): The secondary endpoints of the study include the following: Expanded Disability Status Scale (EDSS): • Time to confirmed (24-weeks CDP) EDSS progression. Progression is defined as 1-point worsening when EDSS score ≤5.5, or 0.5 if baseline score >5.5) • Expanded Disability Status Scale (EDSS): Absolute and ordinal change from baseline considering all measurements up to Week 96 • Time to EDSS score of 7.0, Clinical Global Assessment Tools: • Timed 25-foot walk (T25-FW) from baseline up to Week 96 and 12 weeks confirmed worsening using 20% threshold • Nine-hole peg test (9-HPT), right and left hands sides (finger dexterity) from baseline up to Week 96 and 12 weeks confirmed worsening using 20% threshold • The Symbol Digit Modalities Test (SDMT) from baseline up to Week 96 and 12 weeks confirmed worsening using 4-point threshold, Brain MRI Assessments: • Brain Volume and Lesions will be measured and assessed at Baseline, Week 48 and Week 96, or early termination (only if patient discontinues after Week 48 and more than 24 weeks have elapsed since last MRI) for the following endpoints: Brain atrophy - Percent brain volume change (PBVC) from baseline at Week 96 or early termination • New/newly enlarged T2 lesion count (compared with baseline MRI scan) at Week 96 or early termination, Quality of Life assessment: • Quality of life assessment: Multiple Sclerosis Quality of Life (MSQOL)-54 instrument from baseline up to Week 96 • Modified Fatigue Impact Scale (MFIS) from baseline up to Week 96 • Hamilton Depression Rating Scale (HAM-D) from baseline up to Week 96 • Disability Impact Profile (DIP) from baseline up to Week 96, Relapses: • Occurrence of new or worsening neurological symptoms attributable to MS • Symptoms persisting for >24 hours • Symptoms not attributable to confounding clinical factors (e.g., fever, infection, injury, adverse reactions to medications) • Symptoms immediately preceded by a stable or improving neurological state for at least 30 days • Ssymptoms accompanied by objective neurological worsening consistent with an increase of at least half a step on the EDSS scale, Biomarker(s): • Comparison of serum Neurofilament Light Chain (NfL) and Glial Fibrillary Acidic Protein (GFAP) levels at Baseline and Week 96 or early termination (only if patient discontinues after Week 48 and more than 24 weeks have elapsed since last test) These biomarkers are to be tested in a subgroup of 200 patients of pre-selected sites

Source: https://euclinicaltrials.eu/ctis-public/view/2024-516672-16-00